EU clinical trial 2023-508303-20-01: Evaluation of p-glycoprotein alterations in treatment-resistant depression: a [18F]MC225 PET study
Protocol code: P-gp-TRD
Sponsor: Fondazione Policlinico Universitario Agostino Gemelli IRCCS (Hospital/Clinic/Other health care facility). Phase: Therapeutic exploratory (Phase II). Countries: Italy (ongoing, recruiting).
Therapeutic area(s): Psychiatry and Psychology [F] - Mental Disorders [F03]
Gender: Female, Male. Age: 18-64 years, 65+ years. Enrolment: 44.
Status: Ongoing, recruiting. Start date (EU): 2025-07-14. Decision date: 2025-04-16. Results received: No. Last updated: 2025-04-16.

Condition(s): depression
Product: 18FMC225_FPG

Primary endpoint: To assess between groups differences as for whole-brain DV and SUV of [18F]MC225 (outcome variables) in TRD and DRESP. Overall SUV and DV will be computed as the sum of the 18 VOIs.
Endpoint(s): To assess between groups differences as for DV and SUV of [18F]MC225 in each VOI, both on the right and left latus, in TRD and DRESP, (specifically in TRD subjects) To assess the relationship between [18F]MC225 DV and SUV on the whole brain, and clinical parameters related to the severity of the disease (i.e. duration of disease, number of episodes, number of previous attempted suicides, current episode of attempted suicide, previous psychosis, current psychosis, previous drug abuse, previous pharmacotherapy), (specifically in TRD subjects) To assess the relationship between [18F]MC225 DV and SUV at the level of each VOI, either left or right, and the aforementioned clinical parameters related to the severity of the disease

Source: https://euclinicaltrials.eu/ctis-public/view/2023-508303-20-01